EU clinical trial 2022-502080-38-00: A randomized, parallel-group, 24 week, double-blind, placebo-controlled, multicenter Phase 3 study to assess the efficacy and safety of secukinumab compared to placebo in adult patients with active rotator cuff tendinopathy
Protocol code: CAIN457O12302
Sponsor: Novartis Pharma AG (Pharmaceutical company). Phase: Therapeutic confirmatory (Phase III). Countries: Spain (ended), Hungary (ended), Italy (ended), Denmark (ended), Poland (ended), Greece (ended).
Therapeutic area(s): Diseases [C] - Musculoskeletal Diseases [C05]
Gender: Female, Male. Age: 18-64 years. Enrolment: 128.
Status: Ended. Start date (EU): 2023-10-16. End date (EU): 2024-12-05. End date: 2024-12-11. Decision date: 2023-09-04. Results received: Yes. Last updated: 2024-06-03.
Decision dates by country: HU: 2023-09-11, ES: 2023-09-08, PL: 2023-09-11, IT: 2023-09-11, DK: 2023-09-04, GR: 2023-09-04

Condition(s): Moderate to severe rotator cuff tendinopathy
Product: SECUKINUMAB, Placebo to AIN457 150mg/1mL Solution for injection in pre-filled syringe

Primary endpoint: Change from Baseline (BSL) in the Western Ontario Rotator Cuff Index (WORC) Physical Symptom Domain (PSD) score at Week 16
Endpoint(s): Proportion of participants who achieve an improvement (increase) of at least 40 points from BSL in WORC PSD at Week 16, Proportion of participants receiving AIN457 compared to placebo who achieve an increase of 50 points in WORC Total score at Week 16, Change from BSL in Patient-Reported Outcomes Measurement Information System (PROMIS) - Short Form (SF) Upper Extremity score at Week 16, Proportion of participants who achieve an improvement (increase) of at least 40 points from BSL in WORC PSD at Week 24 Change from BSL in WORC PSD at Week 24, Secukinumab serum concentrations on Day 1 and Weeks 4 and 16, Safety and tolerability demonstrated by assessing: AEs and SAEs (incidence, severity, and relationship with study drug) Incidence of clinically significant changes in laboratory parameters and vital signs Incidence of binding and neutralizing anti-drug antibodies (ADAs) at Day 1 and Week 16

Source: https://euclinicaltrials.eu/ctis-public/view/2022-502080-38-00